EU clinical trial 2025-521504-22-00: CombiVIT Combination approach with ritlecitinib and nbUVB compared to ritlecitinib alone for treating vitiligo Prospective multicentric evaluator blinded interventional study
Protocol code: 25-PP-03
Sponsor: Centre Hospitalier Universitaire De Nice (Hospital/Clinic/Other health care facility). Phase: Therapeutic exploratory (Phase II). Countries: France (ongoing, recruiting).
Therapeutic area(s): Diseases [C] - Skin and Connective Tissue Diseases [C17]
Gender: Female, Male. Age: 18-64 years, 65+ years. Enrolment: 80.
Status: Ongoing, recruiting. Start date (EU): 2025-10-16. Decision date: 2025-08-06. Results received: No. Last updated: 2026-07-03.

Condition(s): Vitiligo
Product: Litfulo 50 mg hard capsules

Primary endpoint: The Facial Vitiligo Area Scoring Index (F-VASI) is a tool allowing to assess the depigmentation of the face. Using the fingertips unit (FTU), it calculates the extent of vitiligo on the face by using the number of FTU [20]. %CFB in F-VASI at Week 52 is defined as %CFB FVASIW0-W52 = (FVASIw0 - FVASIw52)/FVASIw0.
Endpoint(s): 1. The Facial Vitiligo Area Scoring Index (F-VASI) is a tool allowing to assess the depigmentation of the face. Using the fingertips unit (FTU), it calculates the extent of vitiligo on the face by using the number of FTU. A decrease in 50% or more of the initial F-VASI is called F-VASI50 and will define a success., 2. The Facial Vitiligo Area Scoring Index (F-VASI) is a tool allowing to assess the depigmentation of the face. Using the fingertips unit (FTU), it calculates the extent of vitiligo on the face by using the number of FTU. A decrease in 75% or more of the initial F-VASI is called F-VASI 75 and will define a success., 3. A decrease in 90% or more of the initial F-VASI is called F-VASI 90 and will define a success. The number of patients achieving the F-VASI 90 will be assessed at week 24, week 36, week 52 and week 72., 4. T-VASI 50, as define above, will be assessed at week 24, week 36, week 52 and week 72, 5. T-VASI 75, as define above, will be assessed at week 52 and week 72, 6. %CFB in FVASI and %CFB in T-VASI at week 12, week 24, week 36 and week 72 will be define, 7. The Vitiligo Noticeability scale (VNS) will be used as a patient reported outcome. To assess this scale, the patient is asked to compare using a mirror his present state as compared to picture at baseline, 8. The quality of life will be assessed by using VIPs (Vitiligo Impact Patient scale) short form at baseline and week 36, week 52 and week 72., 9. All the adverse events (clinical and biological) occurring over the study period will be collected with their type, grade and severity. At each visit, the investigator will record all the events since the last visit, 10. The patient global impression after treatment will be measured PGIC (F/V) and PGIS (F/V) for each visit, 11. The activity of the disease will be assessed between baseline and week 12, week 24, week 36, week 52 and week 72, using the VSAS score [26] determined by using at least 3 different anatomical lesional locations., 12. Response based on stabilization of disease, defined as: <15-point increase in T-VASI score between baseline and week 12, week 24, week 36, week 52 and week 72 visit.

Source: https://euclinicaltrials.eu/ctis-public/view/2025-521504-22-00